EU clinical trial 2024-515759-39-00: Does placement of a TAP block in patients undergoing laparoscopic inguinal hernia repair have a more efficacious analgesic effect than local infiltration at the surgical site: a randomized controlled trial.
Sponsor: Universitair Ziekenhuis Brussel (Hospital/Clinic/Other health care facility). Phase: Therapeutic use (Phase IV). Countries: Belgium (ongoing, recruiting).
Therapeutic area(s): Diseases [C] - Digestive System Diseases [C06]; Analytical,Diagnostic,Therapeutic Techniques and Equipment [E]-Surgical Procedures, Operative [E04]
Gender: Female, Male. Age: 18-64 years, 65+ years. Enrolment: 80.
Status: Ongoing, recruiting. Start date (EU): 2025-05-13. Decision date: 2024-11-21. Results received: No. Last updated: 2026-06-18.

Condition(s): inguinal hernia
Product: Ropivacaine Fresenius Kabi 7,5 mg/1 ml Solution injectable, NaCl 0,9 % B. Braun, oplossing voor injectie

Primary endpoint: The primary endpoint was the Numeric Rating Scale (NRS) pain score assessed at multiple post-operative time points.
Endpoint(s): The secondary objective is to compare the amount of dipidolor®, expressed in milligrams, given in the PACU and the amount of analgesics used at home

Source: https://euclinicaltrials.eu/ctis-public/view/2024-515759-39-00